EU clinical trial 2025-524327-53-00: Luteal phase support following letrozole treatment in women undergoing intrauterine insemination: a multicenter randomized trial
Protocol code: LIFT
Sponsor: Region Midtjylland (Hospital/Clinic/Other health care facility). Phase: Therapeutic use (Phase IV). Countries: Denmark (authorised, recruitment pending).
Therapeutic area(s): Not possible to specify
Gender: Female. Age: 18-64 years. Enrolment: 690.
Status: Authorised, recruitment pending. Decision date: 2026-03-09. Results received: No. Last updated: 2026-03-09.

Condition(s): Infertility
Product: Cyclogest 400 mg vagitorier

Primary endpoint: Clinical pregnancy rate
Endpoint(s): Live birth rate, Biochemical pregnancy rate, Early pregnancy loss, Fetal miscarriage, Perinatal outcomes: preterm birth, birth weight, congenital malformation, perinatal mortality, Obstetric outcomes: hypertensive disorders of pregnancy, gestational diabetes, postpartum hemorrhage and cesarean section, Hormone levels measured on the day of insemination, mid-luteal phase and ovulation trigger (optional)

Source: https://euclinicaltrials.eu/ctis-public/view/2025-524327-53-00